EU clinical trial 2024-511446-39-00: An Open-Label Phase 2a Clinical Study of the P38 Alpha Kinase Inhibitor Neflamapimod in Patients with Dementia with Lewy Bodies (DLB)
Protocol code: EIP22-NFD-505
Sponsor: Eip Pharma Inc. (Pharmaceutical company). Phase: Therapeutic exploratory (Phase II). Countries: France (ended).
Therapeutic area(s): Diseases [C] - Nervous System Diseases [C10]
Gender: Female, Male. Age: 18-64 years, 65+ years. Enrolment: 25.
Status: Ended. Start date (EU): 2024-08-02. End date (EU): 2026-03-25. Decision date: 2024-06-07. Results received: No. Last updated: 2025-05-12.

Condition(s): Dementia with Lewy Bodies (DLB)
Product: Neflamapimod

Primary endpoint: To evaluate safety and tolerability of 80 mg neflamapimod given twice or three times daily over 24 weeks of dosing, To evaluate multiple dose PK parameters of 80mg BID and 80mg TID
Endpoint(s): Changes in the mean composite score for Alzheimer’s Disease Neuroimaging Initiative Executive Functioning composite scale (ADNI-EF) (Gibbons, et al., 2012) from baseline to 24 weeks, Change in the Clinical Dementia Rating Sum of Boxes (CDR-SB) score from baseline to 24 weeks, Change in Timed Up and Go (TUG) test results from baseline to 24 weeks, Changes in the Mild Behavioral Impairment Checklist (MBI-C) scale, Changes in the Montreal Cognitive Assessment (MOCA), Changes in the Alzheimer’s Disease Cooperative Study –Activities of Daily Living Inventory for Mild Cognitive Impairment (ADCS- ADL-MCI), Changes in the Go no Go task, Change in Dementia Cognitive Fluctuations Scale (DCFS)., Change in hallucinations as measured by the Parkinson’s disease-associated psychotic symptoms questionnaire (PDAP), Change in volume of nucleus basalis of Meynert (NBM) as assessed by structural Magnetic Resonance Imaging (MRI)

Source: https://euclinicaltrials.eu/ctis-public/view/2024-511446-39-00